EU clinical trial 2022-500905-42-00: Phase 1b study investigating the association of NP137 with mFOLFIRINOX in locally advanced pancreatic ductal adenocarcinoma LAP NET 1
Protocol code: 38RC22.0211 LAP NET1
Sponsor: University Hospital Grenoble (Hospital/Clinic/Other health care facility). Phase: Human Pharmacology (Phase I)- Other. Countries: France (ended).
Therapeutic area(s): Diseases [C] - Digestive System Diseases [C06]
Gender: Female, Male. Age: 18-64 years, 65+ years. Enrolment: 52.
Status: Ended. Start date (EU): 2023-03-24. End date (EU): 2025-06-16. Decision date: 2022-11-15. Results received: No. Last updated: 2025-04-08.

Condition(s): pancreatic ductal adenocarcinoma

Source: https://euclinicaltrials.eu/ctis-public/view/2022-500905-42-00